EU clinical trial 2024-515507-18-00: FAST ACUTE SEDATION AT INTENSIVE CARE VS. HIGH-DOSE I.V. ANTI-SEIZURE MEDICATION FOR TREATMENT OF NON-CONVULSIVE STATUS EPILEPTICUS - A RANDOMIZED, MULTICENTER TRIAL (FAST TRIAL)
Sponsor: Odense University Hospital (Hospital/Clinic/Other health care facility). Phase: Therapeutic confirmatory (Phase III). Countries: Denmark (ongoing, recruiting).
Therapeutic area(s): Diseases [C] - Nervous System Diseases [C10]
Gender: Female, Male. Age: 18-64 years, 65+ years. Enrolment: 154.
Status: Ongoing, recruiting. Start date (EU): 2024-10-09. Decision date: 2024-09-13. Results received: No. Last updated: 2026-01-30.

Condition(s): Status epilepticus
Product: LACOSAMIDE, TOPIRAMATE, BRIVARACETAM, FOSPHENYTOIN SODIUM, LEVETIRACETAM, PROPOFOL, MIDAZOLAM, SODIUM VALPROATE

Primary endpoint: Antallet af patienter med forsat NKSE efter 24 timer i de to grupper (“treatment failure”).
Endpoint(s): Ny neurologisk deficit ved udskrivelse fra afdelingen (eller overflytning til en anden hospitalsafdeling), som har gennemført akutbehandlingen. Neurologisk status vurderes ved brug af National Institute of Health Stroke Scale (NIHSS). Neurologisk status forud NKSE estimeres på basis af de foreliggende oplysninger i patientjournalen., Indflydelsen af cEEG på nye neurologiske deficits (varigheden af NKSE hos patienter med og uden cEEG)., Indlæggelsestid, Død under indlæggelsen, Tid på intensiv afdeling, Antal af infektioner under indlæggelsen (defineret som klinisk eller radiologisk diagnose OG opstart af anti-biotisk relevant behandling), Forværring af modfied Rankin score indeks ved udskrivelsen, Antal af patienter med superrefraktær status epilepticus, Overlevelsen efter 3, 6, 12 og 24 måneder efter randomisering, Livskvalitet efter udskrivelsen

Source: https://euclinicaltrials.eu/ctis-public/view/2024-515507-18-00